EU clinical trial 2023-509087-20-00: C3441021 - TALAPRO 2: A PHASE 3, RANDOMIZED, DOUBLE-BLIND, PLACEBO-CONTROLLED STUDY OF TALAZOPARIB WITH ENZALUTAMIDE IN METASTATIC CASTRATION-RESISTANT PROSTATE CANCER.
Protocol code: C3441021
Sponsor: Pfizer Inc. (Pharmaceutical company). Phase: Therapeutic confirmatory (Phase III). Countries: Norway (ended), Poland (ongoing, recruitment ended), Portugal (ongoing, recruitment ended), Sweden (ended), Germany (ended), France (ongoing, recruitment ended), Finland (ongoing, recruitment ended), Hungary (ended), Italy (ongoing, recruitment ended), Czechia (ongoing, recruitment ended), Belgium (ended), Spain (ongoing, recruitment ended).
Therapeutic area(s): Diseases [C] - Neoplasms [C04]
Gender: Male. Age: 18-64 years, 65+ years. Enrolment: 411.
Start date (EU): 2019-04-16. Decision date: 2024-10-21. Results received: No. Last updated: 2026-03-23.
Decision dates by country: HU: 2024-10-21, DE: 2024-10-30, PT: 2024-10-24, IT: 2024-11-13, FI: 2024-10-22, SE: 2024-10-23, NO: 2024-10-28, BE: 2024-10-24, FR: 2024-10-22, CZ: 2024-11-18, PL: 2024-10-23, ES: 2025-01-10

Condition(s): Metastatic Castration-resistant Prostate Cancer
Product: TALAZOPARIB, TALAZOPARIB, TALAZOPARIB, Xtandi - 40 mg soft capsules, TALAZOPARIB

Primary endpoint: * Part1: • Occurrence of target safety events., *Part 2: • BICR assessed rPFS per RECIST 1.1 (soft tissue disease) and PCWG3 (bone disease) in participants with mCRPC unselected for DDR status., *Part 2: • BICR assessed rPFS per RECIST 1.1 (soft tissue disease) and PCWG3 (bone disease) in participants with mCRPC harboring DDR deficiencies.
Endpoint(s): *Part1: • Multiple dose PK parameters of talazoparib and enzalutamide and its N desmethyl metabolite (Multiple dose Cmax, Ctrough, Tmax, AUC and CL/F as data permit)., *Part 2: • OS in participants with mCRPC unselected for DDR status (alpha protected)., *Part 2:• OS participants with mCRPC harboring DDR deficiencies (alpha protected).

Source: https://euclinicaltrials.eu/ctis-public/view/2023-509087-20-00